EU clinical trial 2023-505309-18-00: A Phase 1b/2 Multicentre, Open-label, Modular, Dose-finding and Dose-expansion Study to Explore the Safety, Tolerability, and Anti-tumour Activity of Trastuzumab Deruxtecan (T-DXd) in Combination with other Anti-cancer Agents in Patients with HER2-positive Metastatic Breast Cancer (DESTINY-Breast07)
Protocol code: DESTINY-Breast07
Sponsor: AstraZeneca AB (Pharmaceutical company). Phase: Phase I and Phase II (Integrated)- Other. Countries: Spain (ongoing, recruitment ended), Poland (ongoing, recruitment ended), Italy (ongoing, recruitment ended), Germany (ended).
Therapeutic area(s): Diseases [C] - Neoplasms [C04]
Gender: Female, Male. Age: 18-64 years, 65+ years. Enrolment: 46.
Start date (EU): 2021-01-21. Decision date: 2024-06-13. Results received: No. Last updated: 2026-08-03.
Decision dates by country: PL: 2024-06-17, DE: 2024-06-13, IT: 2024-06-17, ES: 2024-06-17

Condition(s): HER2-positive Metastatic Breast Cancer
Product: MYCOPHENOLATE MOFETIL, PERTUZUMAB, INFLIXIMAB, DS-8201a, IMFINZI 50 mg/mL concentrate for solution for infusion.

Primary endpoint: Part 1: AEs, SAEs, DLTs, laboratory findings, Part 2: AEs, SAEs, laboratory findings
Endpoint(s): Part 1 and Part 2: ORR is defined as the proportion of patients who have a CR or PR, as determined by the Investigator at local site per RECIST 1.1., Part 1 and Part 2: PFS is defined as time from the date of randomisation until the date of progression as assessed by the Investigator at local site per RECIST 1.1, or death due to any cause., Part 2: PFS2 is defined as time from the date of randomisation until the date of progression on next line treatment (the earliest of the progression event subsequent to first subsequent anticancer therapy) or death; second progression will be defined according to local standard clinical practice., Part 2: DoR is defined as time from the date of first documented response until the date of documented progression or death in the absence of disease progression., Part 2: OS is defined as time from the date of randomisation until the date of death due to any cause., Serum concentration of T-DXd, total anti-HER2 antibody, MAAA- 1181a, durvalumab, and pertuzumab; plasma concentration of paclitaxel and tucatinib, Immunogenicity for T-DXd, durvalumab, and pertuzumab

Source: https://euclinicaltrials.eu/ctis-public/view/2023-505309-18-00